EU clinical trial 2023-510249-79-00: A Phase IIa/IIb, randomised, double blind, placebo-controlled, parallel-group dose-finding study to examine the efficacy and safety of BI 1839100 administered orally over a 12-week treatment period in patients with idiopathic pulmonary fibrosis or progressive pulmonary fibrosis with clinically meaningful cough
Protocol code: 1490-0004
Sponsor: Boehringer Ingelheim International GmbH, Boehringer Ingelheim Espana S.A. (Pharmaceutical company). Phase: Therapeutic exploratory (Phase II). Countries: Belgium (ended), Czechia (ended), Poland (ended), Germany (ended), Sweden (ended), Spain (ended), Italy (ended), Finland (ended), Austria (ended), France (ended), Greece (ended), Denmark (ended), Norway (ended), Netherlands (ended), Hungary (ended).
Therapeutic area(s): Diseases [C] - Respiratory Tract Diseases [C08]
Gender: Female, Male. Age: 18-64 years, 65+ years. Enrolment: 100.
Status: Ended. Start date (EU): 2024-09-10. End date (EU): 2025-09-02. End date: 2025-09-03. Decision date: 2024-08-23. Results received: No. Last updated: 2025-07-11.
Decision dates by country: GR: 2024-08-26, IT: 2024-08-26, DK: 2024-08-28, FI: 2024-08-27, ES: 2024-08-27, HU: 2024-08-30, FR: 2024-08-23, NL: 2024-08-27, CZ: 2024-08-28, AT: 2024-09-02, SE: 2024-08-28, NO: 2024-08-23, DE: 2024-08-26, PL: 2024-08-30, BE: 2024-08-26

Condition(s): Progressive pulmonary fibrosis (PPF), Idiopathic pulmonary fibrosis (IPF)
Product: BI 1839100, Placebo matching in size, weight, colour and shape to tablets of BI 1839100

Primary endpoint: IPF cohort - Phase IIa: Change from baseline in 24-h cough frequency (CC/h) at Week 4, IPF cohort - Phase IIa: Change from baseline in 24-h cough frequency (CC/h) at Week 12
Endpoint(s): IPF cohort - Phase IIa: Absolute change from baseline in Cough Severity NRS score at Week 4, IPF cohort - Phase IIa: Absolute change from baseline in Cough Severity VAS score (mm) at Week 4, IPF cohort - Phase IIb: Cough responder status, defined as a ≥30% 24-h cough frequency reduction (CC/h) from baseline at Week 12, IPF cohort - Phase IIb: Absolute change from baseline in FVC (mL) at Week 12, IPF cohort - Phase IIb: Absolute change from baseline in Cough Severity NRS score at Week 12

Source: https://euclinicaltrials.eu/ctis-public/view/2023-510249-79-00